EU clinical trial 2025-521555-23-00: Clindamycin as an alternative to vancomycin in patients undergoing aortic cardiac surgery with extracorporeal circulation (ECC): a prospective single-center pharmacokinetic study _ CLINDAPASS
Protocol code: RC24_0549
Sponsor: Centre Hospitalier Universitaire De Nantes (Hospital/Clinic/Other health care facility). Phase: Therapeutic exploratory (Phase II). Countries: France (ongoing, recruiting).
Therapeutic area(s): Diseases [C] - Bacterial Infections and Mycoses [C01]; Diseases [C] - Cardiovascular Diseases [C14]
Gender: Female, Male. Age: 18-64 years, 65+ years. Enrolment: 30.
Status: Ongoing, recruiting. Start date (EU): 2026-04-21. Decision date: 2025-09-22. Results received: No. Last updated: 2026-06-19.

Condition(s): Patients undergoing cardiac surgery with extracorporeal circulation (ECC)
Product: CLINDAMYCIN

Primary endpoint: 1) a) Estimated free plasma clindamycin concentration throughout surgery. It will be estimated at incision, then every hour, and at the end of surgery. If clindamycin is re-injected during surgery (surgery > 4h), the free plasma clindamycin concentration will be estimated: just before re-injection, then at the end of re-injection, then every hour and at the end of surgery., 1) b) The free plasma concentration of clindamycin is estimated by measuring the total plasma concentration of clindamycin, based on a bound fraction of 80 to 94%. The epidemiological threshold MIC for S. aureus (ECOFF = 0.25 mg/L for clindamycin) was chosen for comparison with clindamycin concentrations, given that this bacterium is the main one implicated in mediastinitis.
Endpoint(s): 1) a) Volume of distribution, clearance, elimination half-life, amount of intraoperative vascular filling (in ml), including blood transfusions: number and type of intraoperative LBP, 1) b) Collection of weight, height (calculation of BMI), collection of usual post-EEC biological data at H+6 and H+24 (creatinemia with calculation of GFR, ASAT/ALAT, total and conjugated bilirubinemia, PAL, γ-GT, protidemia with addition of α-1 acid glycoprotein at induction), qualitative record of CYP3A4/5 inducer/inhibitor drugs, EEC modalities (duration, type and quantity of priming solution, type of cardioplegia, body temperature), blood transfusion and volume reprocessed by Cell-Saver©, 1) c) Tissue determination of clindamycin in pericardial fat and correlation with plasma levels, 2) Record of AEs and SAEs from first injection to discharge from hospital, and any clinical signs indicative of anaphylaxis on medical examination, 3) Recording of clindamycin injection duration, time of reinjections and duration of reinjections, calculation of delta between time of end of clindamycin injection and start of surgical incision, 4) Rate of postoperative mediastinitis from Day0 to 3 months postoperative, defined as a postoperative nosocomial cardiac surgery infection at the surgical site (mediastinum) requiring repeat surgery (drainage lavage) and prolonged antibiotic therapy. Collection of data from the patient's file, as the patient was systematically referred to the Nantes University Hospital. Collection of bacterial ecology, 5) Mortality at 3 months (telephone call), 6) a) Volume of distribution, clearance, elimination half-life of cefazolin, 6) b) Tissue determination of cefazolin in pericardial fat and correlation with plasma levels of cefazolin and clindamycin

Source: https://euclinicaltrials.eu/ctis-public/view/2025-521555-23-00